EU clinical trial 2023-506232-32-00: Evaluation of EXL01 a new Live Biotherapeutic Product to prevent recurrence of Clostridioides difficile infection in high-risk patients. LIVEDIFF
Protocol code: 69HCL22_0980
Sponsor: Hospices Civils De Lyon (Hospital/Clinic/Other health care facility). Phase: Phase I and Phase II (Integrated)- Other. Countries: France (ongoing, recruiting).
Therapeutic area(s): Diseases [C] - Digestive System Diseases [C06]
Gender: Female, Male. Age: 18-64 years, 65+ years. Enrolment: 56.
Status: Ongoing, recruiting. Start date (EU): 2024-04-08. Decision date: 2023-11-20. Results received: No. Last updated: 2026-06-08.

Condition(s): Multiple recurrences of Clostridioides difficile infection treated with oral Vancomycin
Product: This is provided by the product owner, EXL01, VANCOMYCIN

Primary endpoint: Phase I: Occurrence of serious adverse events (CTCAE grade≥3) during treatment and follow-up and discontinuation due to adverse events attributed to treatment. Phase II: Proportion of patients at S8 after the start of treatment who had a recurrence of toxigenic C. difficile defined as ≥3 loose stools per day for more than 48 hours + detection of C. difficile toxin in stool (enzyme-linked immunosorbent assay or toxigenic culture +/- PCR) resulting in the initiation of specific treatment for CDI.
Endpoint(s): Phase I: Proportion of patients at S8 after the start of treatment who had a recurrence of toxigenic C. difficile defined as ≥3 liquid stools per day for more than 48 hours + detection of C. difficile toxin in stool (enzyme-linked immunosorbent assay or toxigenic culture +/- PCR) resulting in the initiation of specific treatment for CDI., Phase II: Occurrence of adverse events (CTCAE grade≥3) during treatment and follow-up and discontinuation of treatment due to adverse events, Digestive symptoms are measured at each visit by : o The number of bowel movements per day over the last 24 hours, using the stool calendar o Stool consistency assessed using the Bristol scale over the last 24 hours using the stool calendar o Abdominal discomfort assessed by a validated irritable bowel syndrome scale (IBS-SSS) at S8 and M4, Patient quality of life at S8 and M4 measured by a quality of life questionnaire validated in digestive diseases (IBS-QOL), percentage of patients with a recurrence of C. difficile infection at M4, Level of F. prausnitzii (qPCR) in stools at S8 versus S0, Level of F. prausnitzii (qPCR) in faeces at M4 versus S0, Composition of intestinal microbiota (determined by 16S rRNA sequencing or shotgun) at each visit, percentage of patients at each visit with a positive fecal toxigenic C. difficile test (PCR) and considered to be in clinical remission, percentage of patients with a recurrence of C. difficile infection requiring hospitalisation at S8, percentage of patients with a recurrence of C. difficile infection requiring hospitalisation at M4, percentage of patients with a recurrence of C. difficile infection requiring surgery at S8, percentage of patients with a recurrence of C. difficile infection requiring surgery at M4

Source: https://euclinicaltrials.eu/ctis-public/view/2023-506232-32-00